EU clinical trial 2023-503248-15-00: CRITICS-II: A multicentre randomized phase II trial of neo‐adjuvant chemotherapy followed by surgery vs. neo‐adjuvant chemotherapy and subsequent chemoradiotherapy followed by surgery vs. neo‐adjuvant chemoradiotherapy followed by surgery in resectable gastric cancer
Protocol code: M15CRI
Sponsor: Stichting Het Nederlands Kanker Instituut-Antoni Van Leeuwenhoek Ziekenhuis (Hospital/Clinic/Other health care facility). Phase: Therapeutic exploratory (Phase II). Countries: Netherlands (ongoing, recruitment ended).
Therapeutic area(s): Diseases [C] - Neoplasms [C04]
Gender: Female, Male. Age: 18-64 years, 65+ years. Enrolment: 207.
Status: Ongoing, recruitment ended. Start date (EU): 2017-10-09. Decision date: 2024-06-18. Results received: No. Last updated: 2025-12-29.

Condition(s): Patients with TNM 8th ed stage IB-IIC gastric adenocacinoma
Product: CAPECITABINE, OXALIPLATIN, CARBOPLATIN, PACLITAXEL, DOCETAXEL

Primary endpoint: Event‐free survival at 1 year after randomisation (events: local recurrence, regional recurrence, local‐regional recurrence or progression, distant recurrence, or death from any cause).

Source: https://euclinicaltrials.eu/ctis-public/view/2023-503248-15-00